EU clinical trial 2024-513803-15-00: Non-Steroidal Anti-Inflammatory Drugs (NSAIDs) versus Conventional Treatment in Acute Myocarditis
Sponsor: Centro Nacional De Investigaciones Cardiovasculares Carlos III, Fundacion Para La Investigacion Biomedica Del Hospital Universitario Puerta De Hierro Majadahonda (Laboratory/Research/Testing facility, Patient organisation/association). Phase: Therapeutic use (Phase IV). Countries: Spain (ongoing, recruiting).
Therapeutic area(s): Diseases [C] - Cardiovascular Diseases [C14]
Gender: Female, Male. Age: 18-64 years, 65+ years. Enrolment: 150.
Status: Ongoing, recruiting. Start date (EU): 2025-01-30. Decision date: 2024-09-16. Results received: No. Last updated: 2025-12-02.

Condition(s): Acute myocarditis
Product: IBUPROFEN

Primary endpoint: Change in late gadolinium enhancement (measured in % relative to indexed myocardial mass) compared to baseline (cardiac magnetic resonance at admission) in each treatment group at 6 months after diagnosis.

Source: https://euclinicaltrials.eu/ctis-public/view/2024-513803-15-00